EU clinical trial 2023-509143-27-00: IL Believe: A Phase 1/2, Open-Label, Dose Escalation and Dose Expansion Study to Investigate the Safety and Tolerability of TransCon IL-2 β/γ Alone or in Combination with Pembrolizumab, TransCon TLR7/8 Agonist, or Other Anticancer Therapies, in Adult Participants with Locally Advanced or Metastatic Solid Tumor Malignancies
Protocol code: ASND0029
Sponsor: Ascendis Pharma Oncology Division A/S (Pharmaceutical company). Phase: Phase I and Phase II (Integrated)- First administration to humans. Countries: Belgium (ended), Poland (ended), Italy (ongoing, recruitment ended), Spain (ongoing, recruitment ended).
Therapeutic area(s): Diseases [C] - Neoplasms [C04]
Gender: Female, Male. Age: 18-64 years, 65+ years. Enrolment: 120.
Start date (EU): 2023-11-27. Decision date: 2023-12-15. Results received: No. Last updated: 2025-12-26.
Decision dates by country: IT: 2024-04-17, BE: 2023-12-15, PL: 2024-01-16, ES: 2024-03-22

Condition(s): Locally advanced or metastatic solid tumor malignancies, platinum resistant ovarian cancer, post-anti-pd-1 melanoma, second line or later cervical cancer, neoadjuvant melanoma and neoadjuvant non-small cell lung cancer, post-anti-pd-L1 non-small cell lung cancer, post-anti-pd-L1 small cell lung cancer, second line or later HER2+ breast cancer
Product: TransCon TLR7/8 Agonist, TransCon IL-2 ß/ү, KEYTRUDA 25 mg/mL concentrate for solution for infusion

Primary endpoint: "Incidence and severity of serious adverse events and adverse events (all Parts)"
Endpoint(s): Parts 1 and 2; Part 3, Cohorts 3, 4, 5, 8, 9, 10, 11, 12, 13; and Part 4: • Objective response rate (ORR) by Response Evaluation Criteria in Solid Tumors (RECIST 1.1), duration of response (DoR), and time to response (TTR) per independent central review (ICR) • ORR by RECIST 1.1, DoR, and TTR per investigator assessment, Parts 1 and 2; Part 3, Cohorts 3, 4, 5, 8, 9, 10, 11, 12, 13; and Part 4: • Progression-free survival (PFS) by RECIST 1.1 per ICR • PFS by RECIST 1.1 per investigator assessment • Overall Survival (OS), Part 3 Neoadjuvant Cohorts (melanoma in Cohorts 6a-c, and non-small cell lung cancer in Cohort 7) • ORR prior to surgery by RECIST 1.1 per ICR • ORR prior to surgery by RECIST 1.1 per investigator assessment • Pathologic complete response (pCR) per central assessment for pathology review, Part 3 Neoadjuvant Cohorts (melanoma in Cohorts 6a-c, and non-small cell lung cancer in Cohort 7): • Major pathologic response (MPR) per central assessment for pathology review • pCR per local assessment for pathology review • MPR per local assessment for pathology review • Event-free survival (EFS) by RECIST 1.1 per ICR • EFS by RECIST 1.1 per investigator assessment • OS, TransCon IL-2 β/γ and Free IL-2 β/γ PK parameters, alone or in combination with pembrolizumab, or SOC chemotherapy, or TransCon TLR7/8 Agonist, or in combination with pembrolizumab and SOC chemotherapy, or in combination with SOC trastuzumab or SOC trastuzumab emtansine (T-DM1)

Source: https://euclinicaltrials.eu/ctis-public/view/2023-509143-27-00